EU clinical trial 2024-519706-13-00: Single vs. dual antiplatelet therapy in elderly or HBR patients undergoing percutaneous intervention with drug-coated balloons (PICCOLETO IV-EPIC 38)
Protocol code: PICCOLETO IV-EPIC 38
Sponsor: Fondazione Ricerca e Innovazione Cardiovascolare (Patient organisation/association). Phase: Therapeutic use (Phase IV). Countries: Italy (ongoing, recruiting), Spain (ongoing, recruiting), Luxembourg (ongoing, recruiting), Belgium (ongoing, recruiting).
Therapeutic area(s): Diseases [C] - Cardiovascular Diseases [C14]
Gender: Female, Male. Age: 18-64 years, 65+ years. Enrolment: 576.
Status: Ongoing, recruiting. Start date (EU): 2026-01-26. Decision date: 2025-07-23. Results received: No. Last updated: 2025-12-09.
Decision dates by country: BE: 2025-07-23, LU: 2025-07-25, ES: 2025-07-30, IT: 2025-07-28

Condition(s): Patients with Stable or Unstable coronary syndromes who have undergone successful PCI
Product: ACETYLSALICYLIC ACID, ACETYLSALICYLIC ACID, CLOPIDOGREL, CLOPIDOGREL

Primary endpoint: Primary endpoint of the study will be the rate of Net Adverse Clinical Events (NACE) at 12 months, defined as the composite of MACE and clinically relevant bleeding events (BARC 2, 3, or 5), for which superiority of the SAPT arm over DAPT is hypothesized.
Endpoint(s): Procedural success (final % stenosis <30%, distal TIMI 3 flow and absence of inhospital major adverse events); (Expected Rate: 95%), Patient-oriented composite endpoint (PoCE), a composite of all-cause death, all MIs, or any repeat revascularization, Cardiovascular and cardiac death (Expected Rate: 1-2%), All-cause death (Expected Rate: 3-5%), Q-wave MI (Expected Rate: 0.5-1%), Any MI (Expected Rate: 3-4%), TLR (Expected Rate: 2-3%), TVR (Expected Rate: 3-4%), Acute vessel occlusion (ARC criteria); (Expected Rate: 4-6%), Transfusion rates (Expected Rate: 1-2%), Functional Status and QoL will be assessed using a validated questionnaire with EQ-5D-5L at baseline, 1 month, 6 months, and 12 months. Rate for QoL/Functional Status: (Improvement: ≥5% increase in score from baseline; Deterioration: ≥5% decrease in score from baseline; No Change: ±5% change from baseline), BARC 2, 3, or 5 bleedings (superiority in study group is expected)

Source: https://euclinicaltrials.eu/ctis-public/view/2024-519706-13-00